EU clinical trial 2023-506885-30-00: Multicenter randomized Phase III trial evaluating contact X-ray brachytherapy for rectal preservation in intermediate substage rectal adenocarcinoma (TRESOR)
Protocol code: 2023/3684
Sponsor: Institut Gustave Roussy (Hospital/Clinic/Other health care facility). Phase: Therapeutic confirmatory (Phase III). Countries: France (ongoing, recruiting).
Therapeutic area(s): Diseases [C] - Neoplasms [C04]; Diseases [C] - Digestive System Diseases [C06]
Gender: Female, Male. Age: 18-64 years, 65+ years. Enrolment: 212.
Status: Ongoing, recruiting. Start date (EU): 2024-03-26. Decision date: 2023-10-27. Results received: No. Last updated: 2026-06-03.

Condition(s): Adult patients with intermediate low or mid rectal adenocarcinoma to be treated with total neoadjuvant therapy (TNT) potentially eligible for rectal preservation.
Product: FOLINATE DE CALCIUM AGUETTANT 100 mg, poudre pour solution injectable, FLUOROURACILE ACCORD 50 mg/ml, solution à diluer pour perfusion, OXALIPLATINE KABI 5 mg/ml, solution à diluer pour perfusion, IRINOTECAN ACCORD 20 mg/mL, solution à diluer pour perfusion, Capecitabine Accord 150 mg film-coated tablets

Primary endpoint: Survival with organ preservation, defined as a rectum intact, owing to: - no radical TME, - no locoregional regrowth unless amenable to limited curative (R0) salvage surgery by local excision (LE), and no permanent stoma (including a never reversed protective stoma, or a stoma owing to toxicities and/or poor functional outcomes).
Endpoint(s): - Anorectal function: low anterior resection syndrome score (LARS score, appendix 2), - Quality of life : EORTC questionnaires QLQ CR-29 and C-30 (appendix 2), - Safety : toxicity grading of the National Cancer Institute (NCI-CTC v5.0), - Surgical complications: Clavien-Dindo Classification of surgical complications (appendix 3)., - Clinical complete response rates at 7 weeks after nCRT, - Local recurrence rate, Efficacy: overall survival (OS), disease-free survival (DFS), and metastasis-free survival (MFS) rates.

Source: https://euclinicaltrials.eu/ctis-public/view/2023-506885-30-00